EU clinical trial 2025-521006-18-00: NOCANO: Nivolumab as neoadjuvant immunotherapy for patients with Oral CANcer and identification of response-predictive biomarkers in tumour draining lymph NOdes
Protocol code: NOCANO
Sponsor: Karolinska University Hospital (Hospital/Clinic/Other health care facility). Phase: Therapeutic exploratory (Phase II). Countries: Sweden (ongoing, recruiting).
Therapeutic area(s): Diseases [C] - Neoplasms [C04]
Gender: Female, Male. Age: 18-64 years, 65+ years. Enrolment: 60.
Status: Ongoing, recruiting. Start date (EU): 2026-05-12. Decision date: 2025-05-19. Results received: No. Last updated: 2026-01-08.

Condition(s): Oral squamous cell carcinoma (OSCC)
Product: OPDIVO 10 mg/mL concentrate for solution for infusion.

Primary endpoint: Frequency of response measured as Objective Response Rate (ORR) based on the standard RECIST v1.1, Frequency of pathological response measured as pCR (no residual tumour cells in tumor bed or lymph nodes), MPR (≤10% residual viable tumour), pPR (≤50% residual viable tumour), Frequency of volumetric (clinical/radiographic) tumour response
Endpoint(s): Incidence of treatment-related Adverse events (TRAEs), Incidence of Serious adverse events (SAE), Change from baseline in laboratory parameters (including hematologic and biochemical parameters), Change from baseline in vital signs (including heart rate, systolic and diastolic blood pressure, body temperature, respiratory rate), Change from baseline in ECG values, Incidence of surgery delays or surgery cancelation due to disease progression or TRAEs during the neoadjuvant treatment period, Rate of postoperative complications, Incidence of reduced extent of surgical intervention with achieved negative/clear surgical margins (SM) or spared from surgery due to complete response to neoadjuvant therapy, Incidence of immunogenicity as measured by the presence of antidrug antibody (ADA) and neutralizing antibodies (NAb) to nivolumab, Proportion of participants with PFS and EFS at distinct timepoints up to 5-year follow-up, Rate of overall survival at distinct timepoints up to 5-year follow-up, Time to the first event (progression, recurrence or death) and frequency, Change from baseline at distinct timepoints measured by EORTC QLQ-C30 and EORTC QLQ-H&N35, Time to clinically meaningful improvement or deterioration, Change in questionnaire completion rates over time, Incidence of HPV, Correlation of HPV status and response to neoadjuvant therapy as defined RECIST 1.1, Proportion of patients with response at lymph nodes, Change in the number of metastatic lymph nodes

Source: https://euclinicaltrials.eu/ctis-public/view/2025-521006-18-00